EU clinical trial 2022-501587-17-00: A Phase 3, Multicenter, Double-blind Maintenance Study to Assess Long-term Safety, Tolerability, and Efficacy of Rocatinlimab in Adult and Adolescent Subjects With Moderate-to-severe Atopic Dermatitis (AD) (ROCKET-ASCEND)
Protocol code: 20210146
Sponsor: Amgen Inc. (Pharmaceutical company). Phase: Therapeutic confirmatory (Phase III). Countries: Spain (ended), Romania (ended), Portugal (ended), Denmark (ended), Sweden (ended), Germany (ended), Italy (ended), Bulgaria (ended), Slovakia (ended), Finland (ended), Latvia (ended), Slovenia (ended), Croatia (ended), Poland (ended), Austria (ended), Greece (ended), Netherlands (ended), Hungary (ended), France (ended), Belgium (ended), Czechia (ended), Estonia (ended).
Therapeutic area(s): Diseases [C] - Immune System Diseases [C20]
Gender: Female, Male. Age: 0-17 years, 18-64 years, 65+ years. Enrolment: 615.
Status: Ended. Start date (EU): 2023-10-20. End date (EU): 2026-06-22. End date: 2026-07-01. Decision date: 2023-09-25. Results received: No. Last updated: 2026-07-17.
Decision dates by country: SE: 2023-09-28, DK: 2023-09-25, EE: 2023-09-27, NL: 2023-09-26, GR: 2023-09-25, HU: 2023-09-27, LV: 2023-09-29, BG: 2023-10-02, AT: 2023-10-02, PT: 2023-09-27, FI: 2023-09-27, SI: 2023-10-02, DE: 2023-09-28, SK: 2023-09-26, CZ: 2023-09-26, ES: 2023-10-02, RO: 2023-10-02, BE: 2023-10-02, PL: 2023-10-02, HR: 2023-10-02, IT: 2023-09-27, FR: 2023-12-05

Condition(s): Atopic Dermatitis
Product: Placebo for amg 451, Rocatinlimab

Primary endpoint: Treatment-emergent adverse events (including clinically significant changes in laboratory values and vital signs) and serious adverse events
Endpoint(s): Maintaining vIGA-AD™ 0/1 response among subjects achieving vIGA-AD 0/1 response at day 1, Maintaining revised IGA (rIGA™) 0/1 response among subjects achieving rIGA 0/1 response at day one, Maintaining EASI 75 response among subjects achieving EASI 75 response at day 1, Maintaining vIGA-AD 0/1 response and EASI 75 response among subjects achieving vIGA-AD 0/1 response and EASI 75 response at day 1, Maintaining reduction from parent study baseline in worst pruritus NRS score among subjects achieving reduction from parent study baseline in worst pruritus NRS score at day 1

Source: https://euclinicaltrials.eu/ctis-public/view/2022-501587-17-00